EU clinical trial 2023-503696-15-00: Phase IIa randomized, double-blind, and placebo-controlled multicenter split body trial to determine safety, tolerability, and efficacy of repeated doses of ACOU085 for the prevention of hearing loss in testicular cancer patients receiving cisplatin
Protocol code: Acousia Study 02
Sponsor: Acousia Therapeutics GmbH (Pharmaceutical company). Phase: Therapeutic exploratory (Phase II). Countries: Germany (ended).
Therapeutic area(s): Diseases [C] - Otorhinolaryngologic Diseases [C09]
Gender: Male. Age: 18-64 years. Enrolment: 40.
Status: Ended. Start date (EU): 2023-11-10. End date (EU): 2026-03-20. Decision date: 2023-09-28. Results received: No. Last updated: 2025-12-15.

Condition(s): sensorineural hearing loss (SNHL)
Product: The placebo will be manufactured based on the PRD9241568 specifications to match the characteristics (appearance, size) of the IMP, without containing the active ingredient (see IMPD).

Primary endpoint: Proportion of patients showing a difference of ≥10 dB between both ears in at least two frequencies for air conduction in PTA focused on high (4, 6, 8 kHz) and extended high frequencies (10, 12, 14, 16 kHz) between baseline (V1; prior to first initiation of cis-Pt containing chemotherapy) and end of chemotherapeutic cycle 3 (V4; Day 64).
Endpoint(s): Efficacy Protection for single audiometric variables (ie, intra-individual differences between both ears) including pure tone and speech audiometry in quiet and noise as well as otoacoustic emissions (DPOAEs) in terms of verum- vs. placebo-treated ear between V1 (baseline) and V2/V3/V4/V5, as defined in the following:, Proportion of patients showing a difference of ≥10 dB between both ears for speech reception thresholds (SRT) in quiet for the Freiburger numbers and/or the Oldenburger sentence tests, Proportion of patients showing a difference of ≥10 dB between both ears for speech discrimination in quiet at 50 and/or 65 dB SPL for the Freiburger monosyllable speech test, Proportion of patients showing a difference of ≥10 dB between both ears for speech discrimination in noise of ≥1.5 dB SNR for the Oldenburger sentence test (fixed noise at 65 dB SPL), Proportion of patients showing a difference of ≥10 dB between both ears across all (0.25 to 12 kHz) and high frequencies (4 to 12 kHz) calculated as the geometric mean of air conduction hearing thresholds, Proportion of patients showing a difference of ≥5 dB between both ears for otoacoustic emissions, Safety and Tolerability: Changes from baseline (differences in time and between both ears) in terms of facial nerve function (H. Brackmann/Stennert Index), cochlear function (tinnitus level/intensity and tympanometry/stapedius reflex), and vestibular function (nystagmus test and dizziness handicap inventory), Changes from baseline for vital signs, physical examinations, ECGs, and laboratory parameters, Incidence, severity, and relationship of adverse events including injection site or local reactions at both ears during the trial course

Source: https://euclinicaltrials.eu/ctis-public/view/2023-503696-15-00